EU clinical trial 2023-505357-40-00: A Single-Blind randomized trial of High-Dose versus Standard-Dose Inactivated Influenza Vaccine in Adult Patients Treated for an Hematological Cancer (Flu-Hemato-Rando study)
Sponsor: CHU De Liege (Hospital/Clinic/Other health care facility). Phase: Therapeutic confirmatory (Phase III). Countries: Belgium (ongoing, recruiting).
Therapeutic area(s): Diseases [C] - Hemic and Lymphatic Diseases [C15]; Diseases [C] - Immune System Diseases [C20]
Gender: Female, Male. Age: 18-64 years, 65+ years. Enrolment: 180.
Status: Ongoing, recruiting. Start date (EU): 2023-09-18. Decision date: 2023-08-23. Results received: No. Last updated: 2023-08-23.

Condition(s): Hematological cancer
Product: Alpharix-Tetra, suspension injectable en seringue préremplie Vaccin antigrippal (virion fragmenté, inactivé), EFLUELDA, suspension injectable en seringue préremplie Vaccin grippal quadrivalent (inactivé, à virion fragmenté), 60 microgrammes HA/souche

Primary endpoint: First co-primary endpoint : the primary endpoint will be to compare seroconversion to a least one of the four vaccine antigens at 28 days after vaccination in patients randomized in the QIIV-HD versus QIIV-SD vaccine (see 6.3 for the definition of response), Second co-primary endpoint : to define a baseline signature predicting response to the vaccine
Endpoint(s): To compare response to QIIV-HD versus QIIV-SD vaccine for : • Seroconversion rate for the 4 vaccine antigens, • Partial and complete seroprotection rates, • Systemic and local adverse events occurring in the 6 months following vaccination, • Seroconversion to at least one of the four antigens in the 3 groups (multiple myeloma, other B-cell malignancy and myeloid malignancy), • Factors associated with response to the vaccine

Source: https://euclinicaltrials.eu/ctis-public/view/2023-505357-40-00